EU clinical trial 2025-523013-28-00: A Phase II, Multicenter, Randomized, Double-Blind, Placebo-Controlled Study Evaluating the Efficacy and Safety of Inavolisib plus Ribociclib plus Fulvestrant Versus Placebo plus Ribociclib plus Fulvestrant in Patients with Endocrine-Resistant Hormone-Receptor-Positive, HER2-Negative Advanced Breast Cancer with Chromosome 8P Loss and Without a PIK3CA Mutation
Protocol code: CO46274
Sponsor: F. Hoffmann-La Roche AG (Pharmaceutical company). Phase: Therapeutic exploratory (Phase II). Countries: France (ongoing, recruiting), Italy (ongoing, recruiting), Poland (authorised, recruiting), Germany (ongoing, recruiting), Spain (ongoing, recruiting).
Therapeutic area(s): Diseases [C] - Neoplasms [C04]
Gender: Female, Male. Age: 18-64 years, 65+ years. Enrolment: 44.
Start date (EU): 2026-04-07. Decision date: 2026-03-23. Results received: No. Last updated: 2026-07-21.
Decision dates by country: FR: 2026-03-25, IT: 2026-03-31, ES: 2026-03-31, PL: 2026-04-03, DE: 2026-03-23

Condition(s): Endocrine-Resistant Hormone-Receptor-Positive, HER2-Negative Advanced Breast Cancer with Chromosome 8p Loss and Without PIK3CA Mutation
Product: INAVOLISIB, RIBOCICLIB, FULVESTRANT, INAVOLISIB, RIBOCICLIB, Inavolisib placebo

Primary endpoint: Investigator-Assessed Confirmed ORR
Endpoint(s): PFS, OS, Investigator-assessed DOR, Investigator-assessed CBR, Incidence and severity of adverse events, with severity determined according to the National Cancer Institute Common Terminology Criteria for Adverse Events, Version 5.0 (NCI CTCAE v5.0), Change from baseline in targeted vital signs, Change from baseline in targeted clinical laboratory test results, Presence, frequency of occurrence, severity, and/or degree of interference with daily activities of symptomatic treatment toxicities as assessed through use of the National Cancer Institute (NCI) Patient-Reported Outcome Common Terminology Criteria for Adverse Events (PRO-CTCAE) instrument, Proportion of participants reporting each response option at each assessment timepoint by treatment arm for treatment side-effect bother single-item General Population, Question 5 (GP5) from the Functional Assessment of Cancer Therapy-General questionnaire (FACT-G), Change from baseline/worsening in symptomatic treatment toxicities and treatment side-effect bother as assessed through use of the PRO-CTCAE and FACT-G GP5 item, respectively

Source: https://euclinicaltrials.eu/ctis-public/view/2025-523013-28-00